EU clinical trial 2025-521985-82-00: Efficacy and safety of a combined therapy with Alpha-Lipoic Acid and Benfotiamine in the symptomatic treatment of diabetic sensorimotor polyneuropathy - a prospective, randomized, controlled, parallel group, double-blind, double-dummy 3-arm trial
Protocol code: WOE-DE-2023-2
Sponsor: Woerwag Pharma GmbH & Co. KG (Pharmaceutical company). Phase: Therapeutic exploratory (Phase II). Countries: Hungary (authorised, recruitment pending).
Therapeutic area(s): Diseases [C] - Nutritional and Metabolic Diseases [C18]; Diseases [C] - Nervous System Diseases [C10]
Gender: Female, Male. Age: 18-64 years, 65+ years. Enrolment: 136.
Status: Authorised, recruitment pending. Decision date: 2026-02-18. Results received: No. Last updated: 2026-04-24.

Condition(s): Diabetic sensorimotor polyneuropathy (DSPN)
Product: Thiogamma 600 mg Filmtabletten, Benfogamma Forte, 300 mg, tabletki powlekane

Primary endpoint: Change from baseline measurement to day 112 in neuropathy symptom characteristics
Endpoint(s): Change from baseline measurement to day 28, day 56, and day 84 in neuropathy symptom characteristics, Change from baseline measurement to day 112 in neuropathy symptoms and neurological deficits, Change in sural nerve conduction velocity and sural sensory nerve action potential amplitude from baseline measurement to day 112, Change in the Neuropathy Disability Score (NDS) from baseline measurement to day 56 and day 112, Change in the Neuropathy Total Symptom Score-6 from baseline measurement to day 27, 55, 83 and 111, Changes in maximum pain assessed by NRS (4 weeks) from baseline measurement to day 56 and day 112, Changes in Quality of Life from baseline measurement to day 112, Effects on Patient Global Impression of Change score on days 56, 112, and 126, Treatment emergent adverse events (TEAE), Subjective tolerability by physician and participant, evaluated at day 112, Changes in vital signs (seated blood pressure and heart rate) from baseline measurement (day 0) to days 56 and 112, Changes in safety laboratory data (blood parameters) from screening to day 112

Source: https://euclinicaltrials.eu/ctis-public/view/2025-521985-82-00